EU clinical trial 2024-516091-15-00: A Phase 2 Study of the Efficacy and Safety of a Dose of Donor-Derived CD19-targeted CAR T cells for children and young adults (up to 39 years old) with recurrent or persistent CD19 (+) Acute Leukemia after Allogeneic Hematopoietic Stem Cell Transplantation (Allo-HSCT)
Protocol code: ELPIDA-ALLOCART-01
Sponsor: Nosokomeio Paidon I Agia Sofia (Hospital/Clinic/Other health care facility). Phase: Therapeutic exploratory (Phase II). Countries: Greece (ongoing, recruiting).
Therapeutic area(s): Diseases [C] - Hemic and Lymphatic Diseases [C15]
Gender: Female, Male. Age: 0-17 years, 18-64 years. Enrolment: 8.
Status: Ongoing, recruiting. Start date (EU): 2022-11-23. Decision date: 2024-11-22. Results received: No. Last updated: 2025-06-26.

Condition(s): Relapsed Acute Leukemia
Product: FLUDARABINE PHOSPHATE, DDCART‐CD19, CYCLOPHOSPHAMIDE

Primary endpoint: Proportion of patients entered into complete remission (CR) within 30 days after DDCART-CD19 infusion. DDCART-CD19 product purity and Transduction Efficiency Proportion of patients maintain CR after 6 months, 1 year and 2 year after DDCAR-CD19 T-cell infusion
Endpoint(s): Duration of DDCART cell detection in patients' blood Duration of B-cell aplasia Correlation of DDCART cell and B-cells detection with disease relapse

Source: https://euclinicaltrials.eu/ctis-public/view/2024-516091-15-00